EU clinical trial 2024-513193-22-00: Efficacy, safety and cost-effectiveness of B cell tailored ocrelizumab versus standard ocrelizumab in relapsing remitting multiple sclerosis (BLOOMS): a randomized controlled trial
Sponsor: Amsterdam UMC Stichting (Hospital/Clinic/Other health care facility). Phase: Phase III and phase IV (Integrated). Countries: Netherlands (ongoing, recruitment ended).
Therapeutic area(s): Diseases [C] - Nervous System Diseases [C10]
Gender: Female, Male. Age: 18-64 years, 65+ years. Enrolment: 296.
Status: Ongoing, recruitment ended. Start date (EU): 2022-03-16. Decision date: 2024-09-17. Results received: No. Last updated: 2026-02-03.

Condition(s): Multiple Sclerosis
Product: Ocrevus 300 mg concentrate for solution for infusion

Primary endpoint: The two co-primary end points are the difference of percentage of confirmed relapse-free patients between the two treatment groups after 96 weeks follow-up and the difference of percentage of patients without new/enlarging T2 MRI lesions between the two treatment groups after 96 weeks follow-up.

Source: https://euclinicaltrials.eu/ctis-public/view/2024-513193-22-00